EU clinical trial 2024-517960-45-00: A clinical imaging Study of the changes in [18F]F-AraG uptake following Radiotherapy in Non-small cell lung cancer.
Sponsor: Amsterdam UMC Stichting (Patient organisation/association). Phase: Phase I and Phase II (Integrated)- Other. Countries: Netherlands (ongoing, recruiting).
Therapeutic area(s): Diseases [C] - Neoplasms [C04]
Gender: Female, Male. Age: 18-64 years, 65+ years. Enrolment: 12.
Status: Ongoing, recruiting. Start date (EU): 2024-10-02. Decision date: 2024-10-02. Results received: No. Last updated: 2024-10-02.

Condition(s): Melanoma, Breast Cancer, Non-small Cell Lung Cancer, Esophageal Cancer
Product: NELARABINE

Primary endpoint: To assess the relative change in uptake of [18F]F-AraG in tumor lesions on anti-PD-1 treatment. i. To define tracer uptake in all tumor lesions and lymphoid organs (lymph nodes, spleen) per [ 18F]F-AraG PET scan using the optimized simplified uptake parameter (SUV, TBR, TPR). ii. To assess the changes in uptake between baseline and after 1 and 3 weeks post-RT, respectively.

Source: https://euclinicaltrials.eu/ctis-public/view/2024-517960-45-00